EU clinical trial 2022-502228-34-00: C4891006 - TACTIVE-U: AN INTERVENTIONAL SAFETY AND EFFICACY PHASE 1B/2, OPEN-LABEL UMBRELLA STUDY TO INVESTIGATE TOLERABILITY, PK, AND ANTITUMOR ACTIVITY OF VEPDEGESTRANT (ARV-471/PF-07850327), AN ORAL PROTEOLYSIS TARGETING CHIMERA, IN COMBINATION WITH OTHER ANTICANCER TREATMENTS IN PARTICIPANTS AGED 18 YEARS AND OVER WITH ER+ ADVANCED OR METASTATIC BREAST CANCER, SUB-STUDY A (ARV-471 IN COMBINATION WITH ABEMACICLIB)
Protocol code: C4891006
Sponsor: Pfizer Inc. (Pharmaceutical company). Phase: Phase I and Phase II (Integrated)- Other. Countries: Spain (ongoing, recruitment ended), Italy (ongoing, recruitment ended).
Therapeutic area(s): Diseases [C] - Neoplasms [C04]
Gender: Female, Male. Age: 18-64 years, 65+ years. Enrolment: 18.
Status: Ongoing, recruitment ended. Start date (EU): 2023-12-27. Decision date: 2023-08-14. Results received: No. Last updated: 2026-01-21.
Decision dates by country: IT: 2023-08-14, ES: 2023-08-14

Condition(s): ER +/HER2- Advanced or Metastatic Breast Cancer
Product: PF-07850327 round, Verzenios 100 mg film-coated tablets, Verzenios 50 mg film-coated tablets, Verzenios 150 mg film-coated tablets

Primary endpoint: Phase 1b: DLTs during DLT observation period [Cycle 1]., Phase 2: Confirmed OR (CR or PR) determined by investigator assessment.
Endpoint(s): Phase 1b ad Phase 2: AEs as characterized by type, frequency, intensity as graded by NCI CTCAE version 5.0, timing, seriousness, and relationship to ARV-471 in combination with abemaciclib. •Laboratory test abnormalities as characterized by type, frequency, intensity (as graded by NCI CTCAE version 5.0), and timing., Phase 1b: Confirmed OR (CR or PR) by investigator assessment. • DoR by investigator assessment. • CBR (confirmed CR or PR at any time, or SD ≥24 weeks) by investigator assessment. • PFS by investigator assessment. Phase 2: DoR by investigator assessment. • CBR (confirmed CR or PR at any time, or SD ≥24 weeks) byinvestigator assessment. • PFS by investigator assessment • OS., Phase 1b and Phase 2: Plasma concentrations of ARV-471, ARV-473, abemaciclib, and abemaciclib active metabolites M2, M18 and M20., Phase 2: ctDNA plasma quantitative changes from pre-treatment to evaluate potential predictability of their associations with clinical outcomes., Phase 1b: AUCtau and Cmax of abemaciclib, M2, M18 and M20, with and without coadministration of ARV 471.

Source: https://euclinicaltrials.eu/ctis-public/view/2022-502228-34-00